EU clinical trial 2024-515255-38-00: EMAPALUMAB TREATMENT FOR ANTICIPATED CLINICAL BENEFIT IN SEPSIS DRIVEN BY THE INTERFERON-GAMMA ENDOTYPE (THE EMBRACE TRIAL)
Protocol code: EMBRACE
Sponsor: Hellenic Institute For The Study Of Sepsis (Laboratory/Research/Testing facility). Phase: Therapeutic exploratory (Phase II). Countries: Greece (ended).
Therapeutic area(s): Diseases [C] - Virus Diseases [C02]; Diseases [C] - Bacterial Infections and Mycoses [C01]; Diseases [C] - Respiratory Tract Diseases [C08]
Gender: Female, Male. Age: 18-64 years, 65+ years. Enrolment: 75.
Status: Ended. Start date (EU): 2025-03-12. End date (EU): 2026-03-13. Decision date: 2024-10-21. Results received: No. Last updated: 2025-11-03.

Condition(s): SEPSIS
Product: Sodium Chloride Injection/ DEMO 0,9% w/v, EMAPALUMAB

Primary endpoint: The study primary endpoint is the decrease of SOFA score by the end-of-treatment (EOT). This is defined as either a) at least 1.4 points decrease of mean SOFA score calculated between days 1 and EOT from SOFA score of day 0; OR b) at least 2 points decrease of SOFA at EOT from day 0., Patients dying before the EOT are considered not meeting the primary endpoint. EOT is defined as the day of end of treatment of the study drug for each of the study participants. For patients requiring dosing by day 27, the decrease of the SOFA score is evaluated on day 28.
Endpoint(s): The number of doses required in each group to achieve the SOFA score response by the EOT, 28-day mortality

Source: https://euclinicaltrials.eu/ctis-public/view/2024-515255-38-00